EU clinical trial 2024-515235-29-00: Phase II clinical trial evaluating the safety and efficacy of a tissue engineered autologous skin substitute reconstructive surgery for basal cell carcinoma.
Protocol code: NanoGSkin/CB/2019
Sponsor: Red Andaluza De Diseno Y Traslacion De Terapias Avanzadas Fundacion Publica Andaluza Progreso Y Salud (Hospital/Clinic/Other health care facility). Phase: Therapeutic exploratory (Phase II). Countries: Spain (ongoing, recruiting).
Therapeutic area(s): Diseases [C] - Skin and Connective Tissue Diseases [C17]
Gender: Female, Male. Age: 18-64 years, 65+ years. Enrolment: 15.
Status: Ongoing, recruiting. Start date (EU): 2024-07-09. Decision date: 2024-07-09. Results received: No. Last updated: 2026-07-28.

Condition(s): Reconstructive skin surgery in basal cell cancer (Mohs surgery).
Product: Skin autograft, Autologous skin differentiated adult keratinocytes and fibroblasts cell-sheet expanded in a fibrin-hialuronic acid biological matrix, Autologous skin differentiated adult keratinocytes and fibroblasts cell-sheet expanded in a fibrin-agarose biological matrix

Primary endpoint: Safety: adverse events and adverse reactions, including complications and sequelae in the healing of the surgical injury, making a distinction between early sequelae (hematoma, infection, blistering and graft loss) and late sequelae (necrosis, inflammation, granulation, abnormal healing, retractions, residual ulcers, pigmentation disorders...). Safety variables will be measured both in the surgical lesion and in the donor area, when applicable., Feasibility: surgical suturability, and ability to grasp/adhere to the recipient tissue in the first healing, maintain its integrity and facilitate re-epithelialization of the surgical wound.
Endpoint(s): Efficacy: Percentage of epithelialization of the lesion 3 weeks after the intervention, time until removal of stitches, time until complete epithelialization. Degree of pain (based on a visual analogue scale and analgesic use data). Aesthetic appearance of the lesion according to the POSAS scale (Van de Kar AL, 2005). Quality of life according to the DLQI indices (Finlay AY, 1994) and the SCI (Rhee JS, 2006; Rhee JS, 2007). Rescue surgeries performed., Efficacy: Complementarily, a set of structural characteristics, molecular and functional properties of the skin will be measured in the surgical injury using different study techniques: doppler ultrasound, cutaneous homeostasis study, histological tests of skin biopsies using optical microscopy., Economic evaluation: A set of variables will be measured with the objective of comparatively analyzing the efficiency of the three types of treatments used in the clinical trial.

Source: https://euclinicaltrials.eu/ctis-public/view/2024-515235-29-00